EU clinical trial 2023-510395-31-00: A Phase 3 Study to Evaluate the Efficacy and Safety of Pegozafermin in Subjects with Compensated Cirrhosis due to Metabolic Dysfunction-Associated Steatohepatitis (MASH)
Protocol code: BIO89-100-132
Sponsor: 89bio Inc. (Pharmaceutical company). Phase: Therapeutic confirmatory (Phase III). Countries: Spain (ongoing, recruiting), Hungary (ongoing, recruiting), Netherlands (ongoing, recruiting), Belgium (ongoing, recruiting), Bulgaria (ongoing, recruiting), Germany (ongoing, recruiting), Poland (ongoing, recruiting), France (ongoing, recruiting), Italy (ongoing, recruiting).
Therapeutic area(s): Diseases [C] - Nutritional and Metabolic Diseases [C18]
Gender: Female, Male. Age: 18-64 years, 65+ years. Enrolment: 155.
Status: Ongoing, recruiting. Start date (EU): 2024-10-30. Decision date: 2024-10-04. Results received: No. Last updated: 2026-05-27.
Decision dates by country: IT: 2024-10-07, DE: 2024-10-09, HU: 2024-10-09, BG: 2024-10-10, BE: 2024-10-09, ES: 2024-10-04, NL: 2024-10-14, PL: 2024-10-13, FR: 2024-10-08

Condition(s): Metabolic Dysfunction-Associated Steatohepatitis (MASH) with Compensated Cirrhosis
Product: Placebo for pegozafermin. combined integral administration device: pre-filled syringe - please refer to the impd pegozafermin section 3.2.p.7 container closure system for detailed description., Pegozafermin

Primary endpoint: 1_At interim analysis: Proportion of subjects achieving fibrosis regression, defined as improvement in fibrosis by ≥1 stage, at Month 24 biopsy relative to baseline biopsy, 2_At study completion: Time to First Occurrence of Disease Progression as Measured by Composite of Protocol -Specified Clinical Events
Endpoint(s): 1_At interim analysis and study completion: Change from baseline in ELF score, 2_At interim analysis and study completion: Change from baseline in ALT, 3_At interim analysis and study completion: Change from baseline in FibroScan VCTE, 4_At study completion: Proportion of subjects who develop CSPH, 5_At study completion: Time to progression to large gastric or esophageal varices and/or varices with “red-wale” signs or endoscopic treatment of esophageal or gastric varices, 6_At study completion: Time to clinically important ascites as determined by the onset of Grade ≥2 (clinically apparent) ascites leading to diagnostic paracentesis or initiation of specific treatment for ascites (e.g., diuretics, therapeutic paracentesis, or TIPS), 7_At study completion: Time to overt hepatic encephalopathy (altered mental status without alternate explanation requiring acute medical attention and either initiation of specific therapy or modification of existing treatment)

Source: https://euclinicaltrials.eu/ctis-public/view/2023-510395-31-00